EU clinical trial 2025-521249-25-00: A phase 1/2, open label, multicenter clinical trial investigating the safety, tolerability, pharmacokinetics, and antineoplastic activity of S095035 (MAT2A inhibitor) as a single agent and in combination in adult participants with advanced or metastatic solid tumors with homozygous deletion of MTAP
Protocol code: CL1-95035-001
Sponsor: Institut De Recherches Internationales Servier IRIS (Pharmaceutical company). Phase: Phase I and Phase II (Integrated)- First administration to humans. Countries: Denmark (ended), Italy (ongoing, recruitment ended), Germany (ongoing, recruitment ended), Spain (ongoing, recruitment ended), France (ongoing, recruitment ended).
Therapeutic area(s): Diseases [C] - Neoplasms [C04]
Gender: Female, Male. Age: 18-64 years, 65+ years. Enrolment: 104.
Start date (EU): 2025-10-30. Decision date: 2025-09-26. Results received: No. Last updated: 2026-04-22.
Decision dates by country: ES: 2025-09-29, DE: 2025-10-01, IT: 2025-09-29, DK: 2025-09-26, FR: 2025-09-29

Condition(s): MTAP-deleted advanced or metastatic solid tumors
Product: TNG462, S095035 tablet 25mg, S095035 tablet 50mg, TNG462, TNG462

Primary endpoint: Phase 1: Dose-limiting toxicities (DLTs) associated with S095035 as a single agent and with S095035-TNG462 combination during the first cycle of treatment, Phase 1: Adverse events (AEs) and serious adverse events (SAEs), changes in safety laboratory results, changes in the physical examination, vital signs, electrocardiogram (ECG), and Eastern Cooperative Oncology Group (ECOG) performance status (PS), Phase 2: Per Response Evaluation Criteria in Solid Tumors (RECIST) version 1.1 or Response Assessment in Neuro-oncology (RANO) 2.0 criteria, as assessed by investigator and by blinded independent central review (BICR): - Objective response rate (ORR)
Endpoint(s): Phase 1 and 2: Plasma PK parameters of S095035 as a single agent and in combinaison with TNG462 including, but not limited to, AUC0 t, AUC0-∞, AUCtau,ss, Tmax, Cmax, Ctrough, t½, Vd/F, and CL/F, as data permit., Phase 1: Changes from baseline in plasma concentrations of [commercially confidential information (CCI)] residues during treatment, Phase 1: Per Response Evaluation Criteria in Solid Tumors (RECIST) version 1.1 or Response Assessment in Neuro-oncology (RANO) 2.0 criteria, as per investigator’s assessment: - Objective response rate (ORR) - Best overall response (BOR) - Clinical benefit rate (CBR=complete response [CR] + partial response [PR] + stable disease [SD] ≥24 weeks) - Duration of response (DOR) - Time to response (TTR), Phase 2: Per RECIST version 1.1 or RANO 2.0 criteria, as assessed by investigator and blinded independent central review (BICR): - Best overall response (BOR) - Clinical benefit rate (CBR=complete response [CR] + partial response [PR] + stable disease [SD] ≥24 weeks) - Duration of response (DOR) - Time to response (TTR) - Progression-free survival (PFS) - Overall survival (OS), Phase 2: Incidence and severity of adverse events (AEs) and serious adverse events (SAEs), changes in safety laboratory results, changes in the physical examination, vital signs, electrocardiogram (ECG), and Eastern Cooperative Oncology Group (ECOG) performance status (PS), Phase 2: Frequency of dose interruptions, dose reductions, and measurements of dose intensity

Source: https://euclinicaltrials.eu/ctis-public/view/2025-521249-25-00